EU clinical trial 2025-521947-19-00: A Study of LY3537031 in Participants With Normal Liver Function and With Mild, Moderate, or Severe Liver Impairment
Protocol code: J2S-MC-GZML
Sponsor: Eli Lilly & Co. (Pharmaceutical company). Phase: Human Pharmacology (Phase I)- Other. Countries: Slovakia (ongoing, recruiting), Hungary (ongoing, recruiting).
Therapeutic area(s): Diseases [C] - Digestive System Diseases [C06]
Gender: Female, Male. Age: 18-64 years, 65+ years. Enrolment: 26.
Status: Ongoing, recruiting. Start date (EU): 2025-11-19. Decision date: 2025-10-17. Results received: No. Last updated: 2026-07-21.
Decision dates by country: SK: 2025-10-17, HU: 2025-10-21

Condition(s): Healthy, Hepatic Insufficiency

Source: https://euclinicaltrials.eu/ctis-public/view/2025-521947-19-00